EU clinical trial 2025-522659-24-00: OVACURE-2: Adoptive T cell therapy plus low dose IL-2 (IL-2ld) as first line neoadjuvant therapy in patients with stage III/IV ovarian cancer
Sponsor: Leids Universitair Medisch Centrum (LUMC) (Hospital/Clinic/Other health care facility). Phase: Phase I and Phase II (Integrated)- Other. Countries: Netherlands (authorised, recruitment pending).
Therapeutic area(s): Diseases [C] - Neoplasms [C04]
Gender: Female. Age: 18-64 years, 65+ years. Enrolment: 30.
Status: Authorised, recruitment pending. Decision date: 2025-12-03. Results received: No. Last updated: 2025-12-03.

Condition(s): Ovarian carcinoma
Product: ALDESLEUKIN, TIL cells

Primary endpoint: mmunotherapy related grade III/IV NCI-CTC toxicity
Endpoint(s): All grade NCI CTC toxicity, CD8/CD4/MDSC, M1/2, Treg

Source: https://euclinicaltrials.eu/ctis-public/view/2025-522659-24-00